EU clinical trial 2023-507666-32-00: BIGTIM: Blocking Interferon-γ by ruxolitinib for Treating Inclusion body Myositis: a phase IIb trial.
Protocol code: APHP220829
Sponsor: Assistance Publique Hopitaux De Paris (Hospital/Clinic/Other health care facility). Phase: Therapeutic exploratory (Phase II). Countries: France (ongoing, recruiting).
Therapeutic area(s): Diseases [C] - Immune System Diseases [C20]; Phenomena and Processes [G] - Musculoskeletal and Neural Physiological Phenomena [G11]
Gender: Female, Male. Age: 18-64 years, 65+ years. Enrolment: 80.
Status: Ongoing, recruiting. Start date (EU): 2025-05-27. Decision date: 2024-10-07. Results received: No. Last updated: 2026-05-28.

Condition(s): Inclusion body Myositis
Product: Jakavi 15 mg tablets, Placebo of Jakavi 15mg

Primary endpoint: Improvement of 60 meters for the distance walked during 6-minute (6WMD) from baseline to M12 (6MWD).
Endpoint(s): 1. Safety and tolerance of ruxolitinib in IBM patients: Adverse events according to the MedDRA classification., Therapeutic muscular efficacy of ruxolitinib through change from baseline to M12 of the parameters depending on skeletal muscle involvement: (i) Muscle strengt (ii) Overall muscle status, (iii) Respiratory ability, (iv) Swallowing, (v) Lower limb Quantification of fat replacement of muscle tissue, residual muscle tissue and markers of disease activity using MRI, 3. Improvement or stability between baseline and M12 in quality of life assessed by the scoring through Health Assessment Questionnaire without Disability Index (HAQ-DI), Duke health profile., 4. Quality of the blinding assessed by the New Blinding Index (Bang, 2004).

Source: https://euclinicaltrials.eu/ctis-public/view/2023-507666-32-00